EU clinical trial 2023-509198-22-00: A Phase 3, Randomized, Double-Masked, Placebo-Controlled, Multicenter Study to Evaluate the Efficacy, Safety, Tolerability, Pharmacokinetics, Pharmacodynamics, and Immunogenicity of Efgartigimod PH20 SC Administered by Prefilled Syringe in Adult Participants With Thyroid Eye Disease
Protocol code: ARGX-113-2309
Sponsor: Argenx (Pharmaceutical company). Phase: Therapeutic confirmatory (Phase III). Countries: Latvia (ended), Austria (ended), Italy (ended), Spain (ended), Sweden (ended), France (ended), Germany (ended), Poland (ended), Bulgaria (ended), Slovenia (ended).
Therapeutic area(s): Diseases [C] - Eye Diseases [C11]
Gender: Female, Male. Age: 18-64 years, 65+ years. Enrolment: 48.
Status: Ended. Start date (EU): 2024-10-21. End date (EU): 2025-12-15. Decision date: 2024-09-23. Results received: No. Last updated: 2025-12-11.
Decision dates by country: ES: 2024-09-23, SI: 2025-08-20, FR: 2024-09-26, LV: 2024-09-24, PL: 2025-01-24, IT: 2024-09-25, DE: 2024-09-27, SE: 2024-09-26, AT: 2024-09-29, BG: 2024-09-30

Condition(s): Thyroid Eye Disease (TED)
Product: Vyvgart 1 000 mg solution for injection in pre-filled syringe, Placebo for efgartigimod

Primary endpoint: Percentage of participants who were proptosis responders at Double-Blind treatment period (DBTP) week 24.
Endpoint(s): Change in proptosis measurement in the study eye from baseline to Double-Blind Treatment Period (DBTP) week 24, Change in the total GO-QoL score from baseline to Double-Blind Treatment Period (DBTP) week 24, Percentage of participants with a resolution of diplopia (responders) at Double-Blind Treatment Period (DBTP) week 24.

Source: https://euclinicaltrials.eu/ctis-public/view/2023-509198-22-00